EU clinical trial 2023-508594-84-00: Efficacy of Gembrax Followed by Folfirinox Versus Folfirinox Alone in First Metastatic Line Pancreatic Cancer Patients
Protocol code: PROICM 2021-02 GAB
Sponsor: Institut Regional Du Cancer De Montpellier (Hospital/Clinic/Other health care facility). Phase: Therapeutic exploratory (Phase II). Countries: France (ongoing, recruiting).
Therapeutic area(s): Diseases [C] - Digestive System Diseases [C06]; Not possible to specify; Diseases [C] - Neoplasms [C04]
Gender: Female, Male. Age: 18-64 years, 65+ years. Enrolment: 162.
Status: Ongoing, recruiting. Start date (EU): 2022-01-11. Decision date: 2024-09-19. Results received: No. Last updated: 2025-12-08.

Condition(s): Metastatic pancreatic adenocarcinoma

Source: https://euclinicaltrials.eu/ctis-public/view/2023-508594-84-00